EU clinical trial 2022-502921-16-00: An 18-month low-interventional prospective, multicentre study to assess joint outcomes in patients with haemophilia A or B on prophylaxis with efmoroctocog alfa or eftrenonacog alfa
Protocol code: Sobi.HAEM89-007
Sponsor: Swedish Orphan Biovitrum AB (publ) (Pharmaceutical company). Phase: Therapeutic use (Phase IV). Countries: Hungary (ended), Ireland (ended), Czechia (ended), Italy (not authorised), Croatia (ended), Spain (ended), Romania (ended), France (ended), Slovenia (ended), Bulgaria (ended).
Therapeutic area(s): Diseases [C] - Hemic and Lymphatic Diseases [C15]
Gender: Female, Male. Age: 0-17 years, 18-64 years, 65+ years. Enrolment: 247.
Status: Ended. Start date (EU): 2023-07-21. End date (EU): 2023-12-01. Decision date: 2023-06-13. Results received: Yes. Last updated: 2023-10-16.
Decision dates by country: BG: 2023-06-19, HR: 2023-06-13, CZ: 2023-06-14, HU: 2023-06-16, IE: 2023-06-16, IT: 2023-06-19, RO: 2023-06-15, SI: 2023-06-14, ES: 2023-06-14, FR: 2023-06-13

Condition(s): Hemophilia A and B
Product: ELOCTA 750 IU Powder and solvent for solution for injection, ELOCTA 1500 IU Powder and solvent for solution for injection, ELOCTA 500 IU Powder and solvent for solution for injection, ELOCTA 3000 IU powder and solvent for solution for injection, ALPROLIX 250 IU powder and solvent for solution for injection, ELOCTA 2000 IU Powder and solvent for solution for injection, ELOCTA 4000 IU powder and solvent for solution for injection, ALPROLIX 500 IU powder and solvent for solution for injection, ALPROLIX 1000 IU powder and solvent for solution for injection, ALPROLIX 2000 IU powder and solvent for solution for injection, ALPROLIX 3000 IU powder and solvent for solution for injection, ELOCTA 1000 IU Powder and solvent for solution for injection, ELOCTA 250 IU Powder and solvent for solution for injection

Primary endpoint: Change from baseline in total HEAD-US score up to month 18 (end of study - EOS)
Endpoint(s): Change from baseline in HEAD-US score for hypertrophic synovium at 6, 12 and 18 months, Change from baseline in HEAD-US score for cartilage at 6, 12 and 18 months, Change from baseline in HEAD-US score for bone at 6, 12 and 18 months, Change from baseline in total HJHS at month 18 (EOS), Number and location of target joints at baseline, 6, 12 and 18 months, Total Annualized bleeding rate (ABR), joint ABR, target joint ABR, traumatic/spontaneous ABR, Patient-Reported Outcomes Measurement Information System (PROMIS) physical function/activity scores at baseline and 18 months, PROMIS pain intensity and interference scores at baseline and 18 months, IPAQ-SF scores at baseline and 18 months

Source: https://euclinicaltrials.eu/ctis-public/view/2022-502921-16-00